EU clinical trial 2022-500350-42-01: A Phase 2b/3 Double-Blind, Randomized, Placebo-Controlled Study to Evaluate the Efficacy and Safety of MK-1654 in Healthy Pre-Term and Full-Term Infants
Protocol code: MK-1654-004
Sponsor: Merck Sharp & Dohme Corp. (Pharmaceutical company). Phase: Phase II and Phase III (Integrated). Countries: Romania (ended), Finland (ended), France (ended), Italy (ended), Denmark (ended), Poland (ended), Belgium (ended).
Therapeutic area(s): Phenomena and Processes [G] - Immune system processes [G12]
Gender: Female, Male. Age: 0-17 years. Enrolment: 590.
Status: Ended. Start date (EU): 2022-11-07. End date (EU): 2024-02-12. End date: 2024-07-09. Decision date: 2022-11-07. Results received: Yes. Last updated: 2024-02-20.
Decision dates by country: DK: 2022-11-08, IT: 2022-11-16, RO: 2022-11-11, BE: 2022-11-21, FR: 2022-11-07, FI: 2022-11-10, PL: 2022-11-21

Condition(s): Prevention of RSV

Primary endpoint: Percentage of participants with RSV-associated MALRI, Percentage of participants with solicited injection-site AEs, Percentage of participants with fever, Percentage of participants with solicited systemic AEs, Percentage of participants with anaphylaxis/hypersensitivity AE of special interest (AESI), Percentage of participants with rash AESI, Percentage of participants with ≥1 nonserious AE, Percentage of participants with serious adverse events (SAEs)
Endpoint(s): Percentage of participants with RSV-associated hospitalization, Percentage of participants with RSV-associated MALRI

Source: https://euclinicaltrials.eu/ctis-public/view/2022-500350-42-01